EU clinical trial 2025-522680-14-00: Study of Q702 in Subjects with Relapsed or Refractory Chronic Graft-versus-Host Disease (cGVHD)
Protocol code: QRNT-012
Sponsor: Qurient Co. Ltd. (Pharmaceutical company). Phase: Human Pharmacology (Phase I)- Bioequivalence Study. Countries: Spain (ongoing, recruiting).
Therapeutic area(s): Diseases [C] - Immune System Diseases [C20]
Gender: Female, Male. Age: 18-64 years, 65+ years. Enrolment: 16.
Status: Ongoing, recruiting. Start date (EU): 2025-12-23. Decision date: 2025-11-24. Results received: No. Last updated: 2026-02-23.

Condition(s): Chronic Graft-versus-Host Disease

Source: https://euclinicaltrials.eu/ctis-public/view/2025-522680-14-00